EU clinical trial 2022-502079-49-00: A Phase 3, Randomized, Active-Controlled, Double-Blind Clinical Study to Evaluate a Switch to Doravirine/Islatravir (DOR/ISL 100 mg/0.25 mg) Once-Daily in Participants With HIV-1 Virologically Suppressed on Bictegravir/Emtricitabine/Tenofovir Alafenamide (BIC/FTC/TAF)
Protocol code: MK-8591A-052
Sponsor: Merck Sharp & Dohme LLC (Pharmaceutical company). Phase: Therapeutic confirmatory (Phase III). Countries: Germany (not authorised), France (not authorised), Spain (not authorised), Italy (not authorised).
Therapeutic area(s): Diseases [C] - Virus Diseases [C02]
Gender: Female, Male. Age: 18-64 years, 65+ years. Enrolment: 180.
Status: Not authorised. Decision date: 2023-04-28. Results received: No. Last updated: 2023-05-02.
Decision dates by country: FR: 2023-04-29, DE: 2023-04-28, IT: 2023-05-02, ES: 2023-04-28

Condition(s): HIV-1 infection
Product: Biktarvy 50 mg/200 mg/25 mg film-coated tablets, Placebo to MK-8591A tablets, Biktarvy 50 mg/200 mg/25 mg film-coated tablets, Placebo to Biktarvy

Primary endpoint: Percentage of participants with human immunodeficiency virus type-1 (HIV-1) ribonucleic acid (RNA) ≥50 copies/mL at Week 48, Percentage of participants who experience adverse events (AEs) through Week 48, Percentage of participants who discontinue study intervention due to AEs through Week 48
Endpoint(s): Percentage of participants with HIV-1 RNA ≥50 copies/mL at Week 96, Percentage of participants with HIV-1 RNA <200 copies/mL at Week 48, Percentage of participants with HIV-1 RNA <50 copies/mL at Week 48, Percentage of participants with HIV-1 RNA <200 copies/mL at Week 96, Percentage of participants with HIV-1 RNA <50 copies/mL at Week 96, Change from baseline in CD4+ T-cell count at Week 48, Change from baseline in CD4+ T-cell count at Week 96, Number of participants with viral drug resistance mutations at Week 48, Number of participants with viral drug resistance mutations at Week 96, Percentage of participants who experience AEs through study duration, Percentage of participants who discontinue study intervention due to AEs through study duration

Source: https://euclinicaltrials.eu/ctis-public/view/2022-502079-49-00